EU clinical trial 2026-525823-26-00: Multiple-Dose Study in Healthy Participants Under Fasting Conditions to Evaluate the Bioequivalence of One Film-Coated Mini-Tablet of Indapamide SR 1.5 mg versus One Film-Coated Tablet of Indapamide SR 1.5 mg and to Compare the Bioavailability of One Film-Coated Mini-Tablet of Indapamide SR 1.5 mg versus One Film-Coated Tablet of Indapamide IR 2.5 mg.
Protocol code: S005183-297
Sponsor: Institut De Recherches Internationales Servier IRIS (Pharmaceutical company). Phase: Human Pharmacology (Phase I)- Bioequivalence Study. Countries: Portugal (ended).
Therapeutic area(s): Not possible to specify
Gender: Female, Male. Age: 18-64 years. Enrolment: 48.
Status: Ended. Start date (EU): 2026-04-25. End date (EU): 2026-07-07. Decision date: 2026-04-20. Results received: No. Last updated: 2026-04-20.

Condition(s): No medical condition.

Source: https://euclinicaltrials.eu/ctis-public/view/2026-525823-26-00